EU clinical trial 2023-504802-12-00: A Phase 1/2, Open-Label, Dose-Escalation Trial of GEN3013 in Patients With Relapsed, Progressive or Refractory B-Cell Lymphoma
Protocol code: GCT3013-01
Sponsor: Genmab A/S (Pharmaceutical company). Phase: Phase I and Phase II (Integrated)- First administration to humans. Countries: Finland (ongoing, recruitment ended), Spain (ongoing, recruitment ended), Denmark (ongoing, recruitment ended), Poland (ongoing, recruitment ended), Germany (ongoing, recruitment ended), France (ongoing, recruitment ended), Netherlands (ongoing, recruitment ended), Italy (ongoing, recruitment ended), Sweden (ongoing, recruitment ended).
Therapeutic area(s): Diseases [C] - Neoplasms [C04]
Gender: Female, Male. Age: 18-64 years, 65+ years. Enrolment: 395.
Status: Ongoing, recruitment ended. Start date (EU): 2018-05-16. Decision date: 2024-02-07. Results received: No. Last updated: 2026-02-26.
Decision dates by country: IT: 2024-02-09, FR: 2024-03-19, FI: 2024-02-08, NL: 2024-02-08, DK: 2024-02-07, SE: 2024-02-08, DE: 2024-02-09, PL: 2024-02-16, ES: 2024-02-07

Condition(s): Lymphoma of B-cell origin
Product: DIPHENHYDRAMINE, ANAKINRA, DEXAMETHASONE, Epcoritamab, SILTUXIMAB, PREDNISOLONE, TOCILIZUMAB, PARACETAMOL, Epcoritamab

Primary endpoint: Escalation End Points: - Dose limiting toxicity - Adverse events, Expansion End Points: - Overall response rate (ORR) determined by Lugano criteria as assessed by independent review committee (IRC), Optimization End Points: - Adverse events; Rating of ≥ Grade 2 CRS events
Endpoint(s): Escalation End Points: - Cytokine measures - Laboratory parameters (biochemistry, hematology including immunophenotyping for absolute T-cell and B-cell counts as well as Tcell activation and exhaustion markers) - PK parameters (clearance, volume of distribution and area-under-the concentration- time curve (AUC0-Clast and AUC0-∞), maximum concentration (Cmax), time of Cmax (Tmax), pre dose values, and halflife), Escalation End Points: - Immunogenicity of GEN3013 - Anti-lymphoma activity, i.e. resolution of constitutional symptoms, reduction in tumor size, objective and best response - Duration of response - Progression free survival - Time to next anti-lymphoma therapy - Overall survival, Expansion Efficacy End Points per IRC and Optimization Efficacy End Points per Investigator: - Duration of response (DOR) determined by Lugano criteria - Complete response (CR) rate determined by Lugano criteria - Duration of CR (DoCR) by Lugano criteria - Progression-free survival (PFS) determined by Lugano criteria - Time to response (TTR) determined by Lugano criteria, Expansion Efficacy End Points per IRC and Optimization Efficacy End Points per Investigator: - Objective and best response rate determined by Lymphoma Response to Immunomodulatory Therapy Criteria (LYRIC) - PFS determined by LYRIC - DOR determined by LYRIC - DoCR determined by LYRIC - TTR determined by LYRIC - Overall survival (OS), Expansion Efficacy End Points per IRC and Optimization Efficacy End Points per Investigator: - Time to next (anti-lymphoma) therapy (TTNT) - Rate of MRD negativity - Safety (i.e., adverse events, laboratory parameters, hospitalizations, and cytokine measures), Expansion Efficacy End Points per IRC and Optimization Efficacy End Points per Investigator: - PK parameters (clearance, volume of distribution, Cmax, Tmax, trough concentrations, and half-life) and incidence of ADAs to GEN3013 - Changes in lymphoma symptoms as measured by the Functional Assessment of Cancer Therapy – Lymphoma (FACT-Lym), Expansion Efficacy End Points per IRC and Optimization Efficacy End Points per Investigator: - Rate of ≥ Grade 2 CRS events and all grade CRS events following first full dose Rate of ≥ Grade 2 CRS events and all grade CRS events overall

Source: https://euclinicaltrials.eu/ctis-public/view/2023-504802-12-00